EU clinical trial 2025-521830-27-00: Relative bioavailability and safety study of pasireotide after a single-dose subcutaneous administration in the arm or in the thigh compared to in the abdomen using a ServoPen in healthy subjects.
Protocol code: SOM230-RECAG-PK-612
Sponsor: Recordati AG (Pharmaceutical company). Phase: Human Pharmacology (Phase I)- Other. Countries: Germany (ongoing, recruiting).
Therapeutic area(s): Diseases [C] - Hormonal diseases [C19]
Gender: Female, Male. Age: 18-64 years. Enrolment: 40.
Status: Ongoing, recruiting. Start date (EU): 2026-07-07. Decision date: 2026-02-23. Results received: No. Last updated: 2026-02-23.

Condition(s): Post-bariatric hypoglycaemia

Source: https://euclinicaltrials.eu/ctis-public/view/2025-521830-27-00